EU clinical trial 2024-512876-37-00: A contrast medium sparing strategy using automated Carbon Dioxide Injection during PERIpheral vascular interventions for PREVENTion of Major Adverse Kidney Events (MAKE): the PeriPREVENT randomized controlled trial
Protocol code: PeriPREVENT
Sponsor: Universitaet Leipzig (Educational Institution). Phase: Therapeutic confirmatory (Phase III). Countries: Germany (ongoing, recruiting), Austria (ongoing, recruiting).
Therapeutic area(s): Diseases [C] - Cardiovascular Diseases [C14]
Gender: Female, Male. Age: 18-64 years, 65+ years. Enrolment: 1960.
Status: Ongoing, recruiting. Start date (EU): 2025-04-11. Decision date: 2024-10-25. Results received: No. Last updated: 2026-05-22.
Decision dates by country: AT: 2024-10-29, DE: 2024-10-25

Condition(s): Peripheral Arterial Disease (PAD)
Product: Solutrast 370, 370 mg Iod/ml, Injektionslösung, Imeron 300, 300 mg Iod/ml, Injektionslösung, Infusionslösung, VISIPAQUETM 270 mg/ml Injektionslösung, Optiray 320 mg Iod/ml Injektionslösung/Infusionslösung, VISIPAQUETM 320 mg/ml Injektionslösung, ACCUPAQUE™ 240 Injektionslösung, Jopamiro 370 mg J/ml - Stechampullen, Ultravist®-300, 300 mg Iod/ml, Injektions- oder Infusionslösung oder Lösung zum Einnehmen, Imeron 350, 350 mg Iod/ml, Injektionslösung, Infusionslösung, Imeron 400, 400 mg Iod/ml, Injektionslösung, Infusionslösung, ACCUPAQUE™ 300 Injektionslösung oder Lösung zum Einnehmen, Ultravist®-240, 240 mg Iod/ml, Injektions- oder Infusionslösung, Ultravist®-370, 370 mg Iod/ml, Injektions- oder Infusionslösung oder Lösung zum Einnehmen, Solutrast 250, 250 mg Iod/ml, Injektionslösung, ACCUPAQUE™ 350 Injektionslösung oder Lösung zum Einnehmen, Solutrast 300, 300 mg Iod/ml, Injektionslösung, Solutrast 200, 200 mg Iod/ml, Injektionslösung

Primary endpoint: Major Adverse Kidney Events up to day 90 after intervention (MAKE90)
Endpoint(s): Main Secondary Endpoint: Post-procedural acute kidney injury (AKI), Major Adverse Kidney Events (MAKE) endpoint up to day 7 (MAKE-7), Single components of MAKE90, Major Adverse Kidney Events at 90 days considering a drop in eGFR by at least 40% (instead of 25% as for the primary endpoint) as compared to baseline, Technical success, Procedural success

Source: https://euclinicaltrials.eu/ctis-public/view/2024-512876-37-00